EU clinical trial 2024-520423-88-00: Contribution of PET (positron emission tomography) scans for the preoperative assessment of symptomatic endometriosis lesions: TEP-ENDORUN
Protocol code: 2013/CHU/12
Sponsor: Centre Hospitalier Universitaire De La Reunion (Hospital/Clinic/Other health care facility). Phase: Therapeutic confirmatory (Phase III). Countries: France (ended).
Therapeutic area(s): Analytical, Diagnostic and Therapeutic Techniques and Equipment [E] - Diagnosis [E01]; Diseases [C] - Female Urogenital Diseases and Pregnancy Complications [C13]
Gender: Female. Age: 18-64 years. Enrolment: 15.
Status: Ended. Start date (EU): 2023-12-12. End date (EU): 2025-04-24. Decision date: 2025-01-29. Results received: Yes. Last updated: 2025-01-29.

Condition(s): Endometriosis
Product: Furosemide 10 mg/ml solution for injection, GLUCOTRACE 185 MBq/ml solution injectable, Omnipaque 350 mg I/ml Injektionslösung

Primary endpoint: Total number of endometriosis lesions diagnosed by PET scan in our 10 patients compared with the number of lesions described during surgery., Number of locations identified by PET scan compared with number of locations identified during surgery.
Endpoint(s): SUV threshold to identify endometriosis lesions., Number of lesions visible on PET scan and not visible on MRI, location on PET scan compared with MRI

Source: https://euclinicaltrials.eu/ctis-public/view/2024-520423-88-00